EU clinical trial 2022-502113-28-00: A Phase 3, Open-Label, Randomized Study To Compare the Efficacy and Safety of Odronextamab (REGN1979), an Anti-CD20 x Anti-CD3 Bispecific Antibody, Combined with Chemotherapy versus Rituximab Combined with Chemotherapy in Previously Untreated Participants with Follicular Lymphoma (OLYMPIA-2)
Protocol code: R1979-ONC-2075
Sponsor: Regeneron Pharmaceuticals Inc. (Pharmaceutical company). Phase: Therapeutic confirmatory (Phase III). Countries: Czechia (ongoing, recruiting), Belgium (ongoing, recruiting), Italy (ongoing, recruiting), Spain (ongoing, recruiting), France (ongoing, recruiting), Germany (authorised, recruitment pending), Poland (ongoing, recruiting), Austria (ongoing, recruiting).
Therapeutic area(s): Diseases [C] - Hemic and Lymphatic Diseases [C15]
Gender: Female, Male. Age: 18-64 years, 65+ years. Enrolment: 220.
Start date (EU): 2024-02-01. Decision date: 2023-10-23. Results received: No. Last updated: 2026-06-01.
Decision dates by country: PL: 2023-10-30, AT: 2023-10-30, BE: 2023-10-23, ES: 2023-10-24, CZ: 2023-10-24, IT: 2023-10-24, FR: 2023-10-24, DE: 2023-10-27

Condition(s): Follicular lymphoma
Product: PREDNISOLONE, DOXORUBICIN HYDROCHLORIDE, Odronextamab, Truxima 500 mg concentrate for solution for infusion, VINCRISTINE SULFATE, Truxima 100 mg concentrate for solution for infusion, CYCLOPHOSPHAMIDE, Odronextamab, PREDNISONE

Primary endpoint: Part 1: Incidence of dose limiting toxicities (DLTs) for odronextamab in combination with chemotherapy, Part 1: Incidence of treatment-emergent adverse events (TEAEs) of odronextamab in combination with chemotherapy, Part 1: Severity of treatment-emergent adverse events (TEAEs) of odronextamab in combination with chemotherapy, Part 2: Complete Response rate at 30 months (CR30) assessed by independent central review (ICR)
Endpoint(s): Part 1 and 2: Odronextamab concentrations in serum when administered with chemotherapy, Part 1 and 2: Odronextamab concentrations in serum when administered as monotherapy, Part 1 and 2: Incidence of anti-odronextamab antibodies (ADAs), Part 1 and 2: Titers of ADAs to odronextamab, Part 1 and 2: Incidence of neutralizing antibodies (NAb) to odronextamab, Part 1: Best overall response (BOR) as assessed by the investigator, Part 2: Progression free survival (PFS) as assessed by ICR, Part 2: Event-free survival (EFS) as assessed by ICR, Part 2: CR30 as assessed by local investigator, Part 2: Change in patient reported physical functioning scale scores on the European Organisation for Research and Treatment of Cancer Quality of Life Questionnaire Cancer-30 (EORTC-QLQ-C30), Part 2: PFS as assessed by local investigator, Part 2: EFS as assessed by local investigator, Part 2: Overall Survival (OS), Part 2: Best Overall response (BOR) as assessed by local investigator, Part 2: BOR as assessed by ICR, Part 2: Duration of response (DOR) assessed by ICR, Part 2: DOR as assessed by local investigator, Part 2: Time to next anti-lymphoma treatment (TTNT), Part 2: Incidence of TEAEs, Part 2: Severity of TEAEs, Part 2: Change in patient reported health related quality of life (HRQoL) as measured by EORTC-QLQ-C30, Part 2: Change in cancer disease as measured by EORTC-QLQ-C30, Part 2: Change in treatment related symptoms as measured by EORTC-QLQ-C30, Part 2: Change in patient-reported lymphoma disease as measured by the Lymphoma Subscale of the Functional Assessment of Cancer Treatment-Lymphoma (FACT-LymS), Part 2: Change in treatment-related symptoms as measured by the FACT-LymS, Part 2: Change in patient-reported general health status per EuroQol-5 Dimensions-5 Levels (EQ-5D-5L), Part 2: Change in patient-reported treatment side effects burden per Functional Assessment of Cancer Therapy–General Global Population Item 5 (FACT-5 GP5), Part 2: Change in Patient Global Impression of Severity (PGIS), Part 2: Change in Patient Global Impression of Change (PGIC), Part 2: Change in score of the FACT-G GP5 item in the patient population

Source: https://euclinicaltrials.eu/ctis-public/view/2022-502113-28-00